EU clinical trial 2023-509788-25-00: JAK inhibitor dose TAPering strategy study in low disease activity rheumatoid arthritis patients
Protocol code: RC31/23/0373
Sponsor: Centre Hospitalier Universitaire De Toulouse (Hospital/Clinic/Other health care facility). Phase: Therapeutic use (Phase IV). Countries: France (ongoing, recruiting).
Therapeutic area(s): Diseases [C] - Immune System Diseases [C20]
Gender: Female, Male. Age: 18-64 years, 65+ years. Enrolment: 308.
Status: Ongoing, recruiting. Start date (EU): 2025-06-16. Decision date: 2024-06-03. Results received: No. Last updated: 2024-11-27.

Condition(s): Rheumatoid arthritis
Product: BARICITINIB, UPADACITINIB, TOFACITINIB, FILGOTINIB

Primary endpoint: the proportion of patients still receiving a JAK-inhibitor and being in CDAI low disease activity at 12 months.
Endpoint(s): Disease activity over time assessed by CDAI, SDAI and DAS28 scores., The delay between the inclusion visit and the first flare diagnosed by a physician. Two definitions of flare will be assessed for this criterion: • A flare defined by a CDAI > 10 at any visit. • A major flare at any visit, based on the OMERACT definition which is: o An increase in the DAS28-ESR score of more than 1.2 compared to baseline score, o OR a DAS28-ESR score increase of more than 0.6 compared to the baseline score AND the current DAS28-ESR score being above 3.2., The 12-month cumulative glucocorticoid dose including rescue short course of glucocorticoids and glucocorticoid joint injections., Patient reported outcomes over 12 months including: • Pain assessed by a visual analogic scale of pain (VAS); • Function assessed by the Health Assessment Questionnaire (HAQ); • Flares according to the patient, assessed by the FLARE questionnaire • Fatigue assessed by a visual analogic scale of fatigue and the FACIT-F questionnaire • Quality of life assessed by the EQ-5D-5L and the RAID., The modified van der Heijde Total Sharp Score variation between baseline visit and 12-month visit., The number of adverse events and severe adverse events at 12 months., The number and percentage of patients in CDAI low disease activity at 12 months who could reduce the JAK inhibitor dosage in the dose-tapering arm., Incremental cost-utility and cost-effectiveness ratios (ICUR and ICER) from the collective perspective expressed in terms of cost per QALY for the ICUR and cost per patient without major flares for the ICER, at 12 months., Occupation, level of income and level of education will be recorded to test the impact of socioeconomic characteristics on care costs and efficiency at 12 months.

Source: https://euclinicaltrials.eu/ctis-public/view/2023-509788-25-00